EU clinical trial 2024-516241-39-00: PRO-HEB.Efficacy of Propranolol for the treatment of central nervous system hemangioblastomas in von Hippel-Lindau disease: a randomized controlled clinical trial
Protocol code: APHP210075
Sponsor: Assistance Publique Hopitaux De Paris (Hospital/Clinic/Other health care facility). Phase: Therapeutic confirmatory (Phase III). Countries: France (ongoing, recruiting).
Therapeutic area(s): Diseases [C] - Nervous System Diseases [C10]
Gender: Female, Male. Age: 18-64 years, 65+ years. Enrolment: 85.
Status: Ongoing, recruiting. Start date (EU): 2024-10-16. Decision date: 2024-10-16. Results received: No. Last updated: 2024-10-16.

Condition(s): Von Hippel-Lindau (VHL) disease
Product: PROPRANOLOL

Primary endpoint: Effectiveness will be assessed using the proportion of patients responding to treatment with propranolol at 24 months post-randomization. The treatment response at 24 months will be a binary variable (responder/non-responder), evaluated by two neuroradiologists independently. They will be blinded to the randomization group.
Endpoint(s): To study the safety of use (tolerance) at 24 months post-randomization: All adverse events related to the use of propranolol occurring during the study will be collected, analyzed, and compared between the two treatment arms., To compare the growth rate of hemangioblastomas (HB) between the two treatment arms at 24 months post-randomization: The growth rate of HB will be measured on each MRI (every 6 months) by two neuroradiologists, blinded to the randomization arm. It will be calculated in mm³/month using the function available on the ITK-SNAP imaging software (www.itksnap.org), which allows for accurate measurement of tumor volume (in case of disagreement, a reconciliation session will be organized). The growth r, To compare the extent of peritumoral edema between the two treatment arms: The size of the peritumoral edema will be measured on each MRI (every 6 months) by two neuroradiologists, blinded to the randomization arm., To compare the occurrence of de novo lesions between the two treatment arms: The number of de novo HB will be specified for each patient at each control MRI (every 6 months) by two neuroradiologists, blinded to the randomization arm. A de novo HB is defined as the appearance during follow-up of an HB that did not exist on the initial imaging (or the transition from a non-measurable HB to a measurable state)., To compare the angiogenic profile of HB between the two groups every 6 months through a perfusion sequence with r-CBV measurement for each measurable and perfusable lesion (> 1 cm)., To study the evolution of serum VEGF levels under treatment: Serum VEGF levels will be measured at the start of treatment, then at 12 and 24 months through a simple peripheral venous blood draw., To compare the number of patients requiring surgery between the two treatment arms: The need for surgery will be recorded during patient follow-up (surgery/no surgery). The necessity for surgery will be left to the discretion of the physician responsible for the patient’s follow-up., To compare the degree of autonomy and quality of life of patients between the two treatment arms: The degree of autonomy of each patient will be assessed using the Karnofsky index, mRS, ECOG Performance Status, and SF-36 every 6 months

Source: https://euclinicaltrials.eu/ctis-public/view/2024-516241-39-00